EU clinical trial 2023-509883-89-00: A Phase III, Open-label, Randomised Study of Osimertinib With or Without Datopotamab Deruxtecan (Dato-DXd), as First-line Treatment in Participants With Epidermal Growth Factor Receptor (EGFR) Mutation-positive, Locally Advanced or Metastatic Non-small Cell Lung Cancer (TROPION‑Lung14)
Protocol code: D516NC00001
Sponsor: AstraZeneca AB (Pharmaceutical company). Phase: Therapeutic confirmatory (Phase III). Countries: Germany (ongoing, recruiting), Italy (ongoing, recruiting), Spain (ongoing, recruiting), Poland (ongoing, recruiting), France (ongoing, recruiting).
Therapeutic area(s): Diseases [C] - Neoplasms [C04]
Gender: Female, Male. Age: 18-64 years, 65+ years. Enrolment: 74.
Status: Ongoing, recruiting. Start date (EU): 2025-01-09. Decision date: 2024-11-26. Results received: No. Last updated: 2026-04-07.
Decision dates by country: DE: 2024-11-28, FR: 2025-03-18, IT: 2024-11-27, PL: 2024-12-02, ES: 2024-11-26

Condition(s): Epidermal growth factor receptor (EGFR) mutation-positive, locally advanced or metastatic non squamous non-small cell lung cancer
Product: TAGRISSO 40 mg film-coated tablets, TAGRISSO 80 mg film-coated tablets, Datopotamab deruxtecan

Primary endpoint: PFS is defined as time from randomisation until progression per RECIST 1.1 as assessed by BICR, or death due to any cause (in the absence of progression).
Endpoint(s): 1. OS defined as the time from randomisation until the date of death due to any cause., 2. Central nervous system progression-free survival (CNS PFS) is defined as the time from randomisation until the date of objective CNS progression assessed by CNS BICR or death (by any cause in absence of CNS progression)., 3. PFS is defined as time from randomisation until progression per RECIST 1.1 as assessed by investigator, or death due to any cause (in the absence of progression)., 4. ORR is defined as the proportion of participants who have a confirmed CR or confirmed PR, as determined by BICR (and investigator) per RECIST 1.1., 5. DoR is defined as the time from the date of first documented confirmed response until date of documented progression per RECIST 1.1, as assessed by BICR (and investigator) assessment or death due to any cause. The measure of interest is the median of DoR., 6. Neuro-radiologist assessments according to CNS RECIST 1.1 to determine the presence/absence of CNS lesions at progression in participants without CNS metastases at baseline., 7. PFS2 will be defined as the time from randomisation to the earliest of the progression event (following the initial progression) subsequent to first subsequent anti-cancer therapy, or death.

Source: https://euclinicaltrials.eu/ctis-public/view/2023-509883-89-00